EU clinical trial 2024-512012-21-00: Randomized, double-blind, placebo-controlled, parallel-group Phase 3 study to evaluate the efficacy, safety, and tolerability of SAR440340/REGN3500/itepekimab (anti-IL-33 mAb) in patients with moderate-to-severe chronic obstructive pulmonary disease (COPD)
Protocol code: EFC16819
Sponsor: Sanofi-Aventis Recherche & Developpement (Pharmaceutical company). Phase: Therapeutic confirmatory (Phase III). Countries: Czechia (ended), Germany (ended), Poland (ended), Hungary (ended), Spain (ended), France (ended), Norway (ended), Netherlands (ended), Estonia (ended), Lithuania (ended), Portugal (ended), Bulgaria (ended).
Therapeutic area(s): Diseases [C] - Respiratory Tract Diseases [C08]
Gender: Female, Male. Age: 18-64 years, 65+ years. Enrolment: 747.
Status: Ended. Start date (EU): 2021-04-08. End date (EU): 2025-08-05. End date: 2025-08-28. Decision date: 2024-08-19. Results received: No. Last updated: 2025-03-24.
Decision dates by country: BG: 2024-10-28, CZ: 2024-08-20, EE: 2024-08-23, HU: 2024-08-22, LT: 2024-08-26, PT: 2024-08-28, ES: 2024-08-19, NL: 2024-08-20, NO: 2024-08-20, PL: 2024-08-26, DE: 2024-08-20, FR: 2024-08-20

Condition(s): Chronic Obstructive Pulmonary Disease
Product: Matched placebo for test product, Itepekimab

Primary endpoint: Annualized rate of moderate or severe acute exacerbation of COPD (AECOPD) in former smokers
Endpoint(s): Change from baseline in pre-bronchodilator (BD) forced expiratory volume in 1 second (FEV1) in former smokers, Change from baseline in post-BD FEV1 in former smokers, Change from baseline in pre-BD FEV1 in former smokers, Time to first moderate or severe AECOPD in former smokers, Annualized rate of severe AECOPD in former smokers, Time to first severe AECOPD in former smokers, Annualized rate of corticosteroid-treated AECOPD in former smokers, Change from baseline in Evaluating Respiratory Symptoms in COPD (E-RS:COPD) total score in former smokers, Rate of change in post-BD FEV1 (L) from baseline (post-BD FEV1 slope) in former smokers, Change from baseline in St. George’s Respiratory Questionnaire (SGRQ) total score in former smokers, Proportion of participants with a decrease from baseline of at least 4 points in SGRQ total score in former smokers, Incidence of treatment-emergent adverse events (TEAEs), adverse event of special interests (AESIs), serious adverse events (SAEs), and adverse events (AEs) leading to permanent treatment discontinuation in former smokers, Incidence of potentially clinically significant laboratory test, vital signs, and electrocardiogram (ECGs) abnormalities in former smokers, Functional itepekimab concentrations in serum in former smokers, Incidence of treatment-emergent anti-itepekimab antibodies responses in former smokers, Annualized rate of moderate or severe AECOPD in current smokers, Change from baseline in pre-BD FEV1 in current smokers, Incidence of TEAEs, AESIs, SAEs, and AEs leading to permanent treatment discontinuation in current smokers, Incidence of potentially clinically significant laboratory, vital signs, and ECGs abnormalities in current smokers, Functional itepekimab concentrations in serum in current smokers, Incidence of treatment-emergent anti-itepekimab antibodies responses in current smokers

Source: https://euclinicaltrials.eu/ctis-public/view/2024-512012-21-00